EU clinical trial 2023-504755-26-00: Comparison of Two Antibiotic Regimens for the Treatment of Early Airways Infection With PA in Adults With Bronchiectasis (ANTEIPA)
Protocol code: ANTEIPA
Sponsor: Centre Hospitalier Intercommunal Creteil (Hospital/Clinic/Other health care facility). Phase: Therapeutic exploratory (Phase II). Countries: France (ongoing, recruiting).
Therapeutic area(s): Diseases [C] - Bacterial Infections and Mycoses [C01]; Diseases [C] - Respiratory Tract Diseases [C08]
Gender: Female, Male. Age: 18-64 years, 65+ years. Enrolment: 196.
Status: Ongoing, recruiting. Start date (EU): 2024-10-21. Decision date: 2024-02-20. Results received: No. Last updated: 2026-02-23.

Condition(s): Bronchiectasis
Product: COLISTIMETHATE SODIUM, CIPROFLOXACIN, CEFTAZIDIME PENTAHYDRATE

Primary endpoint: PA-eradication rate 6 months after the start of antibiotic therapy targeting PA
Endpoint(s): Exacerbation assessment at each follow-up visit, with time (in days) between the start of antibiotic therapy against PA and first exacerbation, Exacerbation assessment at each follow-up visit, Quality-of-life and treatment burden assessment using questionnaires, Quality of Life-Bronchiectasis (QOL-B), Bronchiectasis Impact Measure (BIM), Treatment Burden Questionnaire (TBQ) (+ EQ-5D-5L questionnaire for the medico-economic analysis), Detection of PA at 3-month and 1 year, PA-recurrence in sputum (or lower respiratory tract sample, if clinically justified), with time (in days) between the start of antibiotic therapy against PA and first PA-recurrence, Analysis of PA (or other bacteria) susceptibility to ciprofloxacin, if growing on respiratory sample(s) performed between 3 months and 12 months, AE and serious AEs will be recorded during medical interviews and by self-report in the study booklet up to 4 months after the start of treatment, Number of premature ending of one of the treatment in study due to any AE. Compliance to treatment and AEs will be recorded during medical interviews and by self-report in the study booklet during the study treatment period, time (in days), Number of premature ending of one of the treatment in study. Compliance to treatment will be recorded during medical interviews and by self-report in the study booklet during the study treatment period, time (in days), Proportion of non-administered doses of nebulized colistin.Compliance to treatment will be recorded during medical interviews and by self-report in the study booklet during the study treatment period, time (in days), Total cost in each group, total quality adjusted life years (QALYs) in each group, difference in costs /difference in QALYs

Source: https://euclinicaltrials.eu/ctis-public/view/2023-504755-26-00